EU clinical trial 2022-502415-11-00: An Open-Label Extension Study to Assess the Long-Term Safety of Eplontersen (ION-682884) in Patients with Transthyretin-Mediated Amyloid Cardiomyopathy (ATTR-CM)
Protocol code: ION-682884-CS12
Sponsor: Ionis Pharmaceuticals Inc. (Pharmaceutical company). Phase: Therapeutic confirmatory (Phase III). Countries: Belgium (ongoing, recruitment ended), Greece (ongoing, recruitment ended), Germany (ongoing, recruitment ended), Austria (ongoing, recruitment ended), Portugal (ongoing, recruitment ended), Spain (ongoing, recruitment ended), Sweden (ongoing, recruitment ended), Italy (ongoing, recruitment ended), Czechia (ongoing, recruitment ended), Denmark (ongoing, recruitment ended), France (ongoing, recruitment ended), Poland (ongoing, recruitment ended).
Therapeutic area(s): Diseases [C] - Cardiovascular Diseases [C14]
Gender: Female, Male. Age: 18-64 years, 65+ years. Enrolment: 339.
Status: Ongoing, recruitment ended. Start date (EU): 2023-06-16. Decision date: 2023-05-30. Results received: No. Last updated: 2026-07-06.
Decision dates by country: CZ: 2023-09-21, ES: 2023-06-02, GR: 2023-05-31, BE: 2023-05-30, IT: 2023-05-31, DE: 2023-05-31, AT: 2023-06-05, FR: 2023-08-25, SE: 2023-06-02, PT: 2023-07-20, PL: 2025-03-02, DK: 2023-08-29

Condition(s): Transthyretin-Mediated Amyloid Cardiomyopathy (ATTR CM)
Product: ION 682884, ION 682884, Concavit Capsules

Primary endpoint: Description of TEAEs (AE/SAE/AESI), Analysis of change in safety laboratory assessments of interest over time (Platelet count, eGFR, UPCR, LFTs)
Endpoint(s): Analysis of change in clinical and Biomarker assessment of interest and survival: •TTR serum levels •6MWT •Kansas City Cardiomyopathy Questionnaire (KCCQ) • CV-death •All-cause death

Source: https://euclinicaltrials.eu/ctis-public/view/2022-502415-11-00